EU clinical trial 2023-505534-98-00: PHASE Ib STUDY WITH THE COMBINATION OF LB–100 (PP2A INHIBITOR) AND ATEZOLIZUMAB (PD–L1 INHIBI-TOR) IN METASTATIC COLORECTAL CANCER PATIENTS – The CoLBAt Trial
Protocol code: N22CLB
Sponsor: Het Nederlands Kanker Instituut-Antoni van Leeuwenhoek Ziekenhuis Stichting (Hospital/Clinic/Other health care facility). Phase: Human Pharmacology (Phase I)- First administration to humans. Countries: Netherlands (ongoing, recruiting).
Therapeutic area(s): Diseases [C] - Neoplasms [C04]
Gender: Female, Male. Age: 18-64 years, 65+ years. Enrolment: 37.
Status: Ongoing, recruiting. Start date (EU): 2024-08-01. Decision date: 2024-05-02. Results received: No. Last updated: 2026-07-22.

Condition(s): Microsatellite stable colorectal cancer patients
Product: Tecentriq 1,200 mg concentrate for solution for infusion

Primary endpoint: The main study endpoint is to determine the RP2D of LB−100 when administered in combination with standard doses of Atezolizumab, by assessing the maximum tolerated dose and incidences of adverse events.
Endpoint(s): The efficacy will be evaluated using the disease control rate, objective response rate, progression free survival, overall survival and duration of response., A pharmacokinetic profile of Atezolizumab, LB−100 and the active metabolite endothall will be included by measuring plasma concentrations and determining the pharmacokinetic parameters (e.g. maximal plasma concentration, area under the curve, half–life)., Additionally, relevant pharmacodynamics biomarkers will be explored.

Source: https://euclinicaltrials.eu/ctis-public/view/2023-505534-98-00